EU clinical trial 2025-521281-97-00: C5851005 - PADLINK-005: A RANDOMIZED, PHASE 3, OPEN-LABEL STUDY TO EVALUATE PF-08046054/SGN-PDL1V VERSUS DOCETAXEL IN ADULT PARTICIPANTS WITH PREVIOUSLY-TREATED PROGRAMMED CELL DEATH LIGAND 1 (PD-L1) POSITIVE NON-SMALL-CELL LUNG CANCER (NSCLC)
Protocol code: C5851005
Sponsor: Pfizer Inc. (Pharmaceutical company). Phase: Therapeutic confirmatory (Phase III). Countries: Greece (ongoing, recruiting), Italy (ongoing, recruiting), Belgium (ongoing, recruiting), Slovakia (ongoing, recruiting), Czechia (ongoing, recruiting), Germany (ongoing, recruiting), France (ongoing, recruiting), Poland (ongoing, recruiting), Denmark (ongoing, recruiting), Spain (ongoing, recruiting), Netherlands (ongoing, recruiting), Sweden (ongoing, recruiting), Finland (ongoing, recruiting), Bulgaria (ongoing, recruiting).
Therapeutic area(s): Diseases [C] - Neoplasms [C04]
Gender: Female, Male. Age: 18-64 years, 65+ years. Enrolment: 251.
Status: Ongoing, recruiting. Start date (EU): 2025-12-02. Decision date: 2025-11-17. Results received: No. Last updated: 2026-07-06.
Decision dates by country: BG: 2025-11-24, DK: 2025-11-18, NL: 2025-11-20, SE: 2025-11-18, IT: 2025-11-20, BE: 2025-11-17, ES: 2025-11-20, GR: 2025-11-20, FR: 2025-11-21, SK: 2025-11-18, CZ: 2025-11-19, PL: 2025-11-21, DE: 2025-11-20, FI: 2025-11-19

Condition(s): Non-Small Cell Lung Cancer (NSCLC)
Product: DOCETAXEL

Primary endpoint: Overall survival (OS)
Endpoint(s): Confirmed ORR using RECIST v1.1 as assessed by BICR, PFS using RECIST v1.1 as assessed by investigator, Confirmed ORR using RECIST v1.1 as assessed by investigator, DOR using RECIST v1.1 as assessed by BICR, DOR using RECIST v1.1 as assessed by investigator, Type, incidence, severity, seriousness, and relatedness of adverse events (AEs), Mean scores and change from baseline in the global health status/QoL score on the European Organisation for Research and Treatment of Cancer Quality of Life Questionnaire-Core 30 (EORTC QLQ-C30), Mean scores and change from baseline in physical functioning and role functioning scores on the EORTC QLQ-C30, Mean scores and change from baseline in dyspnea, cough, and chest pain scores on the EORTC Quality of Life Cancer Questionnaire – Lung Cancer 13 QLQ-LC13, TTdD in the global health status/QoL score on the EORTC QLQ-C30, TTdD in physical functioning and role functioning scores on the EORTC QLQ-C30, TTdD in the dyspnea, cough, and chest pain scores on the EORTC QLQ-LC13, Plasma concentration at end of infusion and plasma predose concentration for antibody conjugated monomethyl auristatin E (ac-MMAE) and unconjugated monomethyl auristatin E (MMAE) (in PF-08046054 treatment arm only), Incidence of ADAs (in PF-08046054 treatment arm only), PFS using Response Evaluation Criteria in Solid Tumors, Version 1.1 (RECIST v1.1) as assessed by BICR

Source: https://euclinicaltrials.eu/ctis-public/view/2025-521281-97-00